EU clinical trial 2024-519174-39-00: Phase I/II study of anti-CD19 Chimeric Antigen Receptor-Expressing T cells in pediatric patients affected by relapsed/refractory CD19+ Acute Lymphoblastic Leukemia and Diffuse Large B Cell Lymphoma (DLBCL) or Primary Mediastinal B Cell Lymphoma (PML)
Protocol code: CD19-CAR_Lenti
Sponsor: Ospedale Pediatrico Bambino Gesu (Hospital/Clinic/Other health care facility). Phase: Phase I and Phase II (Integrated)- First administration to humans. Countries: Italy (ongoing, recruitment ended).
Therapeutic area(s): Diseases [C] - Hemic and Lymphatic Diseases [C15]
Gender: Female, Male. Age: 0-17 years, 18-64 years. Enrolment: 32.
Status: Ongoing, recruitment ended. Start date (EU): 2021-02-15. Decision date: 2025-01-14. Results received: No. Last updated: 2025-01-14.

Condition(s): Relapsed/refractory CD19+ Acute Lymphoblastic Leukemia and Diffuse Large B Cell Lymphoma or Primary Mediastinal B Cell Lymphoma
Product: FLUDARABINE, CD19-CAR_Lenti, CYCLOPHOSPHAMIDE

Primary endpoint: PHASE I The safety and tolerability of CD19-CAR_Lenti will be assessed by: - Suspected adverse events, and - Suspected serious adverse events As evidenced by clinically relevant: - Changes in clinical laboratory tests (clinical chemistry, hematology, etc). - Changes in vital signs (blood pressure, pulse, respiratory rate and body temperature). - Changes in physical examination. Signs and symptoms assessed may require additional testing as clinically indicated such as ECG, PFT, radiographic studi
Endpoint(s): Secondary Endpoints phase I and II Relapse rate (RR), overall survival (OS), and disease-free survival (DFS) will be evaluated at 1 and 2 years. - The expansion and persistence of CD19-CAR_Lenti will be measured by flow cytometry and qPCR. - The T cell subpopulations of the CD19-CAR_Lenti cells before and after infusion and the exhaustion profile will be measured by flow cytometry - Disease outcome will be correlated with: a) use of either steroids and/or tocilizumab for CRS/Neurotoxicity; b) pr

Source: https://euclinicaltrials.eu/ctis-public/view/2024-519174-39-00